EU clinical trial 2023-504552-10-01: Double-blind, randomised clinical study comparing efficacy and safety of Clindamycin/Tretinoin Gel (10 mg/g + 0.25 mg/g) (Test) vs. Acnatac(R) 10 mg/g + 0.25 mg/g Gel (Reference) vs. Vehicle in patients with papulopustular acne
Protocol code: 23-01/ClindaTret-G
Sponsor: Dermapharm AG (Pharmaceutical company). Phase: Therapeutic confirmatory (Phase III). Countries: Germany (ongoing, recruiting).
Therapeutic area(s): Diseases [C] - Skin and Connective Tissue Diseases [C17]
Gender: Female, Male. Age: 0-17 years, 18-64 years. Enrolment: 675.
Status: Ongoing, recruiting. Start date (EU): 2024-05-14. Decision date: 2024-04-11. Results received: No. Last updated: 2026-04-27.

Condition(s): Papulopustular acne
Product: Acnatac 10mg/g + 0,25mg/g Gel, Clindamycin Tretinoin Gel, Vehicle to Clindamycin Tretinoin Gel

Primary endpoint: Primary efficacy endpoints to be analysed are the percent change in inflammatory lesion count from baseline (Day 0) to week 12 (Day 84) as well as the percent change in total lesion count from baseline (Day 0) to week 12 (Day 84)
Endpoint(s): Percent change from baseline (Visit 1) to Visit 8 (EoT) assessed by the non-inflammatory lesion count as well as the total lesion count, Percent change in inflammatory lesion count, non-inflammatory lesion count and total lesion count between baseline (Visit 1) and Visit 2, Visit 3, Visit 4, Visit 5, Visit 6 and Visit 7, respectively, Absolute changes in inflammatory lesion count, non-inflammatory lesion count and total lesion count between baseline (Visit 1) and Visit 2, Visit 3, Visit 4, Visit 5, Visit 6, Visit 7 and Visit 8, respectively, Proportion of subjects with a clinical response of “success”, i.e. an IGA score of at least 2 grades less than the baseline assessment, at Visit 8., Change of the Investigator`s Global Assessment (IGA) between baseline (Visit 1) and Visit 2, Visit 3, Visit 4, Visit 5, Visit 6, Visit 7 and Visit 8, respectively. Changes will be calculated as baseline- follow-up., Evaluation of the overall therapeutic success by the investigator and patient at Visit 8, Incidence of adverse events (AEs) during the course of the study, Evaluation of tolerability by the investigator and by the patient from Visit 2 to Visit 8 (EoT)

Source: https://euclinicaltrials.eu/ctis-public/view/2023-504552-10-01